EU clinical trial 2023-507687-38-00: A Phase 1b/2 Study to Evaluate the Efficacy and Safety of Investigational Agents as Monotherapy or in Combination With Pembrolizumab for the Treatment of Participants With PD-1/L1-refractory Extensive-Stage Small Cell Lung Cancer in Need of Second-Line Therapy (KEYNOTE-B98)
Protocol code: MK-3475-B98
Sponsor: Merck Sharp & Dohme LLC (Pharmaceutical company). Phase: Phase I and Phase II (Integrated)- Other. Countries: Spain (ongoing, recruitment ended), Hungary (ended), Poland (ongoing, recruitment ended), Austria (ongoing, recruitment ended), Italy (ongoing, recruitment ended).
Therapeutic area(s): Diseases [C] - Neoplasms [C04]
Gender: Female, Male. Age: 18-64 years, 65+ years. Enrolment: 59.
Start date (EU): 2021-08-23. Decision date: 2024-03-27. Results received: No. Last updated: 2026-07-24.
Decision dates by country: HU: 2024-03-27, ES: 2024-03-27, PL: 2024-03-28, AT: 2024-04-08, IT: 2024-03-29

Condition(s): Participants with extensive-stage small cell lung cancer
Product: Raludotatug Deruxtecan, Lenvatinib, MK-4830, MK-4280A, Lenvatinib, KEYTRUDA 25 mg/mL concentrate for solution for infusion, MK-1308A

Primary endpoint: Number of Participants Experiencing Dose-Limiting Toxicities (DLTs), Number of Participants Who Experience at Least One Adverse Event (AE), Number of Participants Who Discontinue Study Treatment Due to an Adverse Event (AE), Objective Response Rate (ORR) Per Response Evaluation Criteria In Solid Tumors Version 1.1 (RECIST 1.1)
Endpoint(s): Progression-free Survival (PFS) Per Response Evaluation Criteria In Solid Tumors Version 1.1 (RECIST 1.1), Duration of Response (DOR) Per Response Evaluation Criteria In Solid Tumors Version 1.1 (RECIST 1.1)

Source: https://euclinicaltrials.eu/ctis-public/view/2023-507687-38-00